EU clinical trial 2024-511639-83-00: ROMIDEPSIN IN COMBINATION WITH CHOEP AS FIRST LINE TREATMENT BEFORE HEMATOPOIETIC STEM CELL TRANSPLANTATION IN YOUNG PATIENTS WITH NODAL PERIPHERAL T-CELL LYMPHOMAS: A PHASE I-II STUDY
Protocol code: FIL_PTCL13
Sponsor: Fondazione Italiana Linfomi Ets (Patient organisation/association). Phase: Phase I and Phase II (Integrated)- Other. Countries: Italy (ended).
Therapeutic area(s): Diseases [C] - Hemic and Lymphatic Diseases [C15]
Gender: Female, Male. Age: 18-64 years. Enrolment: 125.
Status: Ended. Start date (EU): 2014-09-01. End date (EU): 2026-03-25. Decision date: 2024-10-28. Results received: No. Last updated: 2024-10-28.

Condition(s): Anaplastic Large T-cell Lymphoma ALK negative, Angioimmunoblastic T-cell Lymphoma, Peripheral T-cell lymphoma, NOS
Product: Romidepsin

Primary endpoint: Phase I: Incidence of dose-limiting toxicity (DLT) of Ro-CHOEP-21, considering as maximum dose the one causing induction of any grade ≥ 3 non-haematological toxicity or a delay >15 days of planned cycle date observed during the first two cycles according to the definitions of NCI Common Terminology Criteria for Adverse Events (CTCAE), version 4.0 (2009), Phase II: PFS on intention to treatment (ITT) evaluated at 18 months. PFS will be defined as the time between the date of enrolment and the date of disease progression, relapse or death from any cause.
Endpoint(s): Phase I: Proportion of patients reaching SCT, Overall response rate (ORR, defined according to the Lugano Classification 2014 response criteria) of the combination of Ro- CHOEP-21., Phase II: ORR and CR (defined according to the Lugano Classification 2014 response criteria), after Ro-CHOEP-21 and after SCT Event free survival (EFS) induction treatment and after SCT, Phase II: Event free survival (EFS) defined as the time between the date of enrollment and the date of discontinuation of treatment for any reason, Phase II: Overall survival (OS) defined as the time between the date of enrolment and the date of death from any cause in the ITT population enrolled in the study, Phase II: PFS and OS in patients not responding to the first 3 courses of Ro- CHOEP-21, Phase II: Evaluation during the interim analyses of any grade III or higher toxicities, recorded and classified according to the definitions of NCI Common Terminology Criteria for Adverse Events (CTCAE), version 4.0 (2009), Phase II: Evaluation during all the pretransplant phase of any grade III or higher toxicities, recorded and classified according to the definitions of NCI Common Terminology Criteria for Adverse Events (CTCAE), version 4.0 (2009), Phase II. Any grade III or higher toxicities, recorded and classified according to the definitions of NCI Common Terminology Criteria for Adverse Events (CTCAE), version 4.0 (2009), Phase II: Treatment-related mortality defined as any death that was not attributable to the lymphoma., Phase II: Incidence of acute and chronic GVHD in allografted patients

Source: https://euclinicaltrials.eu/ctis-public/view/2024-511639-83-00